EU clinical trial 2024-513911-28-00: Phase 2/3 Adaptive Design, Randomized Double-blind Placebo-controlled Study to Evaluate the Safety and Efficacy of DM199 for the Treatment of Acute Ischemic Stroke (ReMEDy2 Trial)
Protocol code: DM199-2021-001
Sponsor: Diamedica Therapeutics Inc. (Pharmaceutical company). Phase: Phase II and Phase III (Integrated). Countries: Romania (authorised, recruitment pending), Hungary (ongoing, recruiting), Belgium (ongoing, recruiting), Poland (ongoing, recruiting), Spain (ongoing, recruiting), France (authorised, recruitment pending).
Therapeutic area(s): Diseases [C] - Nervous System Diseases [C10]
Gender: Female, Male. Age: 18-64 years, 65+ years. Enrolment: 100.
Start date (EU): 2026-03-04. Decision date: 2025-11-25. Results received: No. Last updated: 2026-07-30.
Decision dates by country: BE: 2025-11-25, HU: 2025-11-26, RO: 2025-11-28, PL: 2025-11-30, ES: 2025-11-28, FR: 2025-11-28

Condition(s): Acute Ischemic Stroke
Product: centrally blinded product containing all the same manufactured ingredients and excipients as the DM199 formulation, except for the active pharmaceutical ingredient (API).

Primary endpoint: Stroke recovery as defined by participants with excellent functional outcomes at Day 90 as assessed via the modified Rankin Score (mRS [dichotomized]), mRS scores of 0 or 1 represent responders, scale range of 0–6., Incidence, severity, and causality of adverse events (AEs) and serious adverse events (SAEs)., Incidence, severity, and causality of adverse events of special interest (AESI)., Tolerability (incidence and severity of injection site adverse reactions)., Change from Baseline in physical examination (PE) at Day 21 and Day 90., Change from Baseline in vital sign measurements (resting heart rate (HR), systolic/diastolic blood pressure (BP), respiratory rate (RR), and body temperature (BT)) at Days 1, 4, 21, and 90., Change from Baseline in hematology and chemistry parameters at Day 4, Day 21, and Day 90., Change from baseline in 12-lead Electrocardiogram (ECG) at Day 1 and Day 90 as determined by the Investigator.
Endpoint(s): Assessment of effect on disability across the full spectrum of AIS by examining the distribution of mRS (shift) scores (scale range = 0 to 6) at Day 90., Proportion of participants achieving independent function (able to look after their own affairs without assistance) with or without minor disability at Day 90 assessed as mRS 0-2 (dichotomized). mRS scores of 0, 1, or 2 represent responders, scale range of 0–6., Mortality rate as defined by event rate (%) for mortality over 90 days., Proportion of participants achieving an excellent neurological outcome defined by NIHSS = 0-1 (dichotomized) (NIHSS scores of 0 or 1, scale range 0 to 42) at Day 90., Proportion of participants achieving an excellent functional independence in activities of daily living defined by Barthel Index score (dichotomized) greater than or equal to 95 (scale range 0 to 100) at Day 90., Recurrent AIS as defined by proportion of participants who experience a recurrent AIS by Day 90 as assessed by a new, persistent neurological deficit attributable to cerebrovascular ischemia. Imaging findings, if available, should support the diagnosis.

Source: https://euclinicaltrials.eu/ctis-public/view/2024-513911-28-00